EU clinical trial 2022-501190-39-01: A Phase 2 Proof of Concept Study to Evaluate the Safety, Tolerability, Pharmacokinetics, Pharmacodynamics, and Preliminary Efficacy of OMS906 in PNH Patients with a Sub-optimal Response to the C5 inhibitor, Ravulizumab
Protocol code: OMS906-PNH-001
Sponsor: Omeros Ireland Limited, Omeros Corp. (Pharmaceutical company). Phase: Human Pharmacology (Phase I)- Other. Countries: Greece (ended), Germany (ended).
Therapeutic area(s): Diseases [C] - Immune System Diseases [C20]
Gender: Female, Male. Age: 18-64 years, 65+ years. Enrolment: 5.
Status: Ended. Start date (EU): 2023-05-15. End date (EU): 2024-10-10. End date: 2024-10-11. Decision date: 2022-11-14. Results received: No. Last updated: 2024-06-13.
Decision dates by country: GR: 2022-11-18, DE: 2022-11-14

Condition(s): Paroxysmal nocturnal hemoglobinuria

Source: https://euclinicaltrials.eu/ctis-public/view/2022-501190-39-01